EU clinical trial 2022-500918-25-00: A pivotal phase 3 clinical trial to assess the diagnostic performance and safety of [68Ga]Ga-PentixaFor ([68Ga]Ga-PTF), a positron emission tomography (PET) imaging agent, versus [18F]FDG PET/CT imaging, for staging of patients with confirmed marginal zone lymphoma (MZL) exemplary for CXCR4-positive malignant lymphomas: a prospective, international, multi-center, comparative, randomized, cross-over, open-label lymphoma diagnostic trial (LYMFOR).
Protocol code: PTF301
Sponsor: Pentixapharm AG (Pharmaceutical company). Phase: Therapeutic confirmatory (Phase III). Countries: Germany (ended), Italy (ended), Spain (ended), France (ended), Austria (ended).
Therapeutic area(s): Diseases [C] - Neoplasms [C04]; Analytical, Diagnostic and Therapeutic Techniques and Equipment [E] - Diagnosis [E01]
Gender: Female, Male. Age: 18-64 years, 65+ years. Enrolment: 148.
Status: Ended. Start date (EU): 2024-05-20. End date (EU): 2025-06-06. Decision date: 2023-11-29. Results received: Yes. Last updated: 2025-07-01.
Decision dates by country: AT: 2023-11-30, IT: 2023-12-04, ES: 2023-11-29, FR: 2023-11-29, DE: 2023-11-30

Condition(s): Marginal Zone Lymphoma
Product: [68Ga]Ga-PentixaFor, FLUDEOXYGLUCOSE (18F)

Primary endpoint: 1. Superiority in terms of sensitivity and non-inferiority in terms of specificity of [68Ga]Ga-PTF PET/CT imaging vs. [18F]FDG PET/CT imaging in tumor detection on a lesion-basis confirmed by SoT (central histopathological confirmation of tumor tissue) or surrogate SoT (central evaluation of clinical and imaging follow-up). (Refer to Protocol for complete information)
Endpoint(s): 3. Assessment of the impact on staging of each PET/CT imaging agent., 4. Assessment of the impact on the intended treatment plan and patient management of each PET/CT imaging agent., 2. Central assessment of the impact on staging of each PET/CT imaging agent., 5. Assessment of the percentage of inter-observer agreement of each PET/CT imaging agent local vs. central in terms of staging., 6. Local and central assessment of the impact on staging of each PET/CT imaging agent and stratification in MZL subtypes., 7. Local and central assessment of the impact on the intended treatment plan and patient management of each PET/CT imaging agent and stratification in MZL subtypes., 8. Central assessment of diagnostic performance, consisting of sensitivity and specificity of each PET/CT imaging agent in tumor detection on a region-basis confirmed by SoT., 9. Assessment of sensitivity of each PET/CT imaging agent in tumor detection on a patient-basis confirmed by SoT., 10. Assessment of diagnostic accuracy of each PET/CT imaging agent to detect tumor lesions on a per patient-basis and lesion-basis confirmed by SoT., 11. Determination of PPV and NPV of each PET/CT imaging agent to detect tumor on a patient-basis and lesion-basis., 12. Tumor detection rate of each PET/CT imaging agent on a patient-basis and on lesion-basis confirmed by SoT or surrogate SoT., 13. Proportion of patients with additional or less lesions detected by [68Ga]Ga-PTF PET/CT imaging compared to [18F]FDG PET/CT imaging., 14. Assessment of the percentage of intra- and inter-reader agreement of each PET/CT imaging agent for tumor detection on a lesion-basis, region-basis and patient-basis., 15. Evaluation of reproducibility of [68Ga]Ga-PTF PET/CT imaging by comparison of two successive [68Ga]Ga-PTF PET/CT scans in a subpopulation of patients., 16. Assessment of the image quality of each PET/CT imaging agent in PET-positive lesions., 17. To evaluate the safety and tolerability of each PET/CT imaging agent.

Source: https://euclinicaltrials.eu/ctis-public/view/2022-500918-25-00